EU clinical trial 2022-500014-26-00: A PHASE III, RANDOMIZED, OPEN-LABEL STUDY EVALUATING THE EFFICACY AND SAFETY OF GIREDESTRANT IN COMBINATION WITH PHESGO VERSUS PHESGO AFTER INDUCTION THERAPY WITH PHESGO+TAXANE IN PATIENTS WITH PREVIOUSLY UNTREATED HER2-POSITIVE, ESTROGEN RECEPTOR-POSITIVE LOCALLY-ADVANCED OR METASTATIC BREAST CANCER
Protocol code: WO43571
Sponsor: F. Hoffmann-La Roche AG (Pharmaceutical company). Phase: Therapeutic confirmatory (Phase III). Countries: Hungary (ongoing, recruitment ended), Italy (ongoing, recruitment ended), Belgium (ongoing, recruitment ended), Poland (ongoing, recruitment ended), France (ongoing, recruitment ended), Germany (ongoing, recruitment ended), Spain (ongoing, recruitment ended), Portugal (ongoing, recruitment ended).
Therapeutic area(s): Diseases [C] - Neoplasms [C04]
Gender: Female, Male. Age: 18-64 years, 65+ years. Enrolment: 218.
Status: Ongoing, recruitment ended. Start date (EU): 2022-06-24. Decision date: 2022-06-16. Results received: No. Last updated: 2026-06-25.
Decision dates by country: PL: 2022-06-21, BE: 2022-07-14, FR: 2022-06-17, DE: 2022-06-20, IT: 2022-06-17, PT: 2022-07-07, HU: 2022-06-17, ES: 2022-06-20

Condition(s): Locally-Advanced unresectable or Metastatic breast cancer (MBC)
Product: PACLITAXEL, ANASTROZOLE, EXEMESTANE, Phesgo 600 mg/600 mg solution for injection, TAMOXIFEN, LETROZOLE, Phesgo 1200 mg/600 mg solution for injection, DOCETAXEL, RO7197597

Primary endpoint: 1. PFS, defined as the time from randomization to the first occurrence of disease progression or death from any cause (whichever occurs first), as determined by the investigator according to RECIST v1.1
Endpoint(s): 1. OS, defined as the time from randomization to death from any cause, 2. ORR (following randomization), defined as the proportion of participants with a CR or partial response (PR) on two consecutive occasions >= 4 weeks apart, as determined by the investigator according to RECIST v1.1, 3. DOR (following randomization), defined as the time from the first occurrence of a documented objective response (complete response (CR) or partial response (PR) to disease progression or death from any cause (whichever occurs first), as determined by the investigator according to RECIST v1.1, 4. CBR (following randomization), defined as the proportion of participants with SD or non-CR/non-PD for ≥ 24 weeks or a CR or PR, as determined by the investigator according to RECIST v1.1, 5. Mean and mean changes from baseline score in function (role, physical) and health-related quality of life (HRQoL) by cycle and between treatment arms as assessed through the use of the Functional and GHS/QoL scales of the EORTC QLQ-C30, 6. Incidence and severity of adverse events, with severity determined according to NCI CTCAE v5.0, 7. Change from baseline in targeted clinical laboratory test results

Source: https://euclinicaltrials.eu/ctis-public/view/2022-500014-26-00